EU clinical trial 2024-517705-93-00: Phase I-II Study to Assess the Safety, Tolerability and Efficacy of PM01183 and Atezolizumab in Patients with Advanced Small Cell Lung Cancer that Progressed Following Prior Therapy with Platinum-Based Chemotherapy
Protocol code: 2SMALL
Sponsor: Fundacion Oncosur (Laboratory/Research/Testing facility). Phase: Phase I and Phase II (Integrated)- Other. Countries: Spain (ended).
Therapeutic area(s): Diseases [C] - Neoplasms [C04]
Gender: Female, Male. Age: 18-64 years, 65+ years. Enrolment: 140.
Status: Ended. Start date (EU): 2019-12-13. End date (EU): 2025-09-30. Decision date: 2024-10-01. Results received: No. Last updated: 2024-10-01.

Condition(s): Histologically or cytologically confirmed diagnosis of extensive or limited SCLC. Progression to first-line platinum-based chemotherapy. Measurable disease according to RECIST v.1.1.
Product: lurbinectedin, Tecentriq 1 200 mg concentrate for solution for infusion

Primary endpoint: Phase 1: Determination of MTD and RD: • The MTD will be the lowest dose level explored during dose escalation at which more than one third of evaluable patients experience a DLT during Cycle 1. • The RD will be the highest dose level explored during dose escalation at which less than one third of evaluable patients experience a DLT during Cycle 1., Phase 1: If the DLTs observed with the PM01183 and atezolizumab combination without G-CSF prophylaxis are exclusively related to neutropenia, the MTD and RD will also be determined with primary G-CSF prophylaxis., Phase 2: The ORR will be assessed using the RECIST v.1.1 on a set of measurable lesions identified at baseline as target lesions or as non-target lesions (if any), and followed until PD by an appropriate method [e.g., helical CT-scan, magnetic resonance imaging (MRI)], using the same method throughout the study for each individual patient., Phase 2 : Adequate CNS imaging (contrast enhanced-CT or MRI, if applicable) will be performed at baseline to document any disease involvement. This assessment will not be repeated routinely unless it is clinically indicated., Phase 2: Radiological tumor assessments will be performed at baseline, and every six weeks (+/- 2 weeks) until evidence of PD or start of a new antitumor therapy. If an objective response according to RECIST v.1.1 is observed, it must be confirmed by the same method at least four weeks after the date of the first documentation of response., Phase 2: Clinically stable patients with suspected pseudoprogression (i.e., tumor growth from treatment effect rather than true disease progression) and perceived clinical benefit by the Investigator, might continue treatment and radiological evaluations despite RECIST-defined progression., Phase 2: The date of response, the date of radiological or clinical PD, and the date of death will be registered and documented, as appropriate.
Endpoint(s): Safety: patients will be evaluable for safety if they have received at least one partial infusion of atezolizumab and PM01183. AEs will be graded according to the National Cancer Institute Common Terminology Criteria for Adverse Events (NCI-CTCAE) v.5., Efficacy: antitumor activity of the combination will be evaluated in terms of: - Progression-free survival; -Duration of response (DoR); -Clinical benefit; -Overall survival (OS); -Mid- and long-term survival, Pharmacokinetics: PK parameters will be evaluated in plasma by standard non-compartmental methods (compartmental modeling may be performed if appropriate)., Pharmacogenetics: factors that may help to explain individual variability in main PK parameters, the presence or absence of germline mutations or polymorphisms that may be involved in the metabolism and/or transport of PM01183 will be analyzed in leukocyte DNA extracted., Pharmacogenomics: In order to determine predictive/prognostic markers of response and/or resistance to PM01183 and atezolizumab, tumor samples available at baseline and blood samples (Day 1 of every cycle and end-of-treatment) will be evaluated in all patients. In addition, on-treatment tumor sample from biopsy (4th to 6th weeks after treatment onset) will be obtained and evaluated for patients consenting to PGx sub-study.

Source: https://euclinicaltrials.eu/ctis-public/view/2024-517705-93-00